EU clinical trial 2022-502932-37-00: A Phase 3, Double-blind, Placebo-controlled, Randomized Withdrawal Study to Evaluate the Efficacy and Safety of SYNB1934 in Patients with PKU (SYNPHENY-3)
Protocol code: SYNB1934-CP-003
Sponsor: Synlogic Inc. (Pharmaceutical company). Phase: Therapeutic confirmatory (Phase III). Countries: Denmark (ended).
Therapeutic area(s): Diseases [C] - Nutritional and Metabolic Diseases [C18]
Gender: Female, Male. Age: 0-17 years, 18-64 years, 65+ years. Enrolment: 11.
Status: Ended. End date (EU): 2024-02-08. End date: 2024-03-15. Decision date: 2024-01-16. Results received: Yes. Last updated: 2024-01-16.

Condition(s): Phenylketonuria
Product: ONDANSETRON, ESOMEPRAZOLE, Placebo to match SYNB1934v1

Primary endpoint: Part 1: Percent change from baseline in blood Phe level at last measurement of the individually titrated dose (iTD) of SYNB1934v1, Part 2: Change from baseline to Week 4 in blood Phe level, Part 3: Incidence and severity of adverse events, Part 3: Changes from DEP baseline in clinical laboratory parameters, Part 3: Changes from DEP baseline in vital signs measurements
Endpoint(s): Part 1: Change from baseline in blood Phe level at last measurement of the iTD of SYNB1934v1, Part 1: A ≥ 20% reduction from baseline in blood Phe level at any time in the DEP, Part 1: Blood Phe level ≤ 360 μmol/L at any time of the iTD of SYNB1934v1, Part 1: Blood Phe level ≤ 360 μmol/L at any time in the DEP, Part 1: Incidence and severity of adverse events, Part 1: Changes from baseline in clinical laboratory parameters, Part 1: Changes from baseline in vital signs measurements, Part 2: Percent change from DEP baseline in blood Phe level at Week 4, Part 2: Change from DEP baseline to Week 4 in blood Phe level, Part 2: Blood Phe level ≤ 360 μmol/L at Week 4, Part 2: Incidence and severity of adverse events, Part 2: Changes from baseline in clinical laboratory parameters, Part 2: Change from baseline in vital signs measurements, Part 2: A ≥ 20% reduction from DEP baseline in blood Phe level at Week 4, Part 3: Change from DEP baseline in blood Phe levels, Part 3: Blood Phe level ≤ 360 μmol/L, Part 3: Change from DEP baseline in blood Phe levels over time, Part 3: Change from DEP baseline in blood Phe level over time until first protocol-specified increase in dietary protein intake, Part 3: Change from DEP baseline in dietary Phe intake.

Source: https://euclinicaltrials.eu/ctis-public/view/2022-502932-37-00